EU clinical trial 2023-510189-28-00: RCT part: CareRA2020: Effectiveness of a combination of Methotrexate and a step down glucocorticoid regimen (COBRA-Slim) for remission induction in patients with early Rheumatoid Arthritis (RA), with or without fast access to 24 weeks of Tumor Necrosis Factor (TNF) blockade in insufficient responders, a randomized, multicenter, pragmatic trial. LTE part: CareRA2020 LTE: a 3 year longitudinal observational, multicenter, follow-up of early RA patients after participation in the CareRA2020 RCT.
Protocol code: S59474; KCE-16002
Sponsor: UZ Leuven (Hospital/Clinic/Other health care facility). Phase: Therapeutic use (Phase IV). Countries: Belgium (ended).
Therapeutic area(s): Diseases [C] - Musculoskeletal Diseases [C05]
Gender: Female, Male. Age: 18-64 years, 65+ years. Enrolment: 442.
Status: Ended. Start date (EU): 2018-05-15. End date (EU): 2025-07-08. Decision date: 2024-02-01. Results received: Yes. Last updated: 2024-02-01.

Condition(s): Rheumatoid Arthritis
Product: Enbrel 50 mg solution for injection in pre-filled pen, LEFLUNOMIDE, Benepali 50 mg solution for injection in pre-filled pen.

Primary endpoint: For the RCT part: Area under the curve of DAS28CRP over 104 weeks (long term effectiveness) in insufficient responders randomized to either COBRA-Slim Bio-Induction or Standard COBRA-Slim Induction., For the LTE part: Area under the curve of DAS28-CRP over 260 weeks (long term effectiveness) in insufficient responders randomized to either COBRA-Slim Bio-Induction or Standard COBRA-Slim Induction.
Endpoint(s): For the RCT part: Proportion of insufficient responders achieving remission (DAS28CRP<2.6) 28 weeks after randomization (short term efficacy) to either COBRA-Slim Bio-Induction or Standard COBRA-Slim Induction., For the RCT part: 1. Clinical efficacy: Remission (DAS28CRP<2.6) at w104, EULAR response at 28 weeks after randomization and at w104, HAQ response at 28 weeks after randomization and at w104; 2. Radiographic progression: X-ray evolution at w52 and w104 compared to BL as reviewed and evaluated by the central team; 3. Side effects: (S)ARs from BL until w104; 4. To evaluate the primary outcome using the DAS28ESR instead of the DAS28CRP., For the LTE part: 1. To further determine the clinical efficacy of the accelerated access to Etanercept strategy versus the classic COBRA Slim strategy; 2. To evaluate the safety of the given treatments.

Source: https://euclinicaltrials.eu/ctis-public/view/2023-510189-28-00